EU clinical trial 2025-524640-35-00: A Study to Evaluate the Long-term Safety and Efficacy of Long-acting Antibodies as Single Agents and in Combinations in Participants with Inflammatory Bowel Disease
Protocol code: SPY123-202
Sponsor: Spyre Therapeutics Inc. (Pharmaceutical company). Phase: Therapeutic exploratory (Phase II). Countries: Croatia (authorised, recruitment pending), Poland (authorised, recruitment pending), Austria (authorised, recruitment pending), Czechia (authorised, recruiting), Italy (authorised, recruitment pending), Slovakia (authorised, recruitment pending), Bulgaria (authorised, recruitment pending), Greece (authorised, recruiting), Belgium (authorised, recruitment pending), Spain (authorised, recruitment pending), Hungary (authorised, recruitment pending), Germany (authorised, recruitment pending), Lithuania (authorised, recruitment pending), France (authorised, recruitment pending), Romania (authorised, recruitment pending).
Therapeutic area(s): Diseases [C] - Digestive System Diseases [C06]
Gender: Female, Male. Age: 18-64 years, 65+ years. Enrolment: 228.
Start date (EU): 2026-08-05. Decision date: 2026-06-16. Results received: No. Last updated: 2026-07-27.
Decision dates by country: AT: 2026-06-21, BE: 2026-06-16, BG: 2026-06-19, HR: 2026-06-19, CZ: 2026-06-16, FR: 2026-06-19, GR: 2026-06-17, HU: 2026-06-16, IT: 2026-06-17, LT: 2026-06-17, RO: 2026-06-18, ES: 2026-06-18, SK: 2026-06-16, PL: 2026-06-18, DE: 2026-07-27

Condition(s): Ulcerative colitis (Inflammatory Bowel Disease)
Product: SPYPBO-101, SPY001-001, SPY002, SPY003

Primary endpoint: Incidence of TEAEs (treatment-emergent adverse event)
Endpoint(s): Endoscopic improvement at Week 48

Source: https://euclinicaltrials.eu/ctis-public/view/2025-524640-35-00